EU clinical trial 2024-519123-14-00: A Randomized, Placebo-controlled, Double-blind, Dose-finding Phase 1b Study to Assess the Safety, Immunogenicity and Pharmacodynamics of TRB-001 in Early Idiopathic Parkinson’s Disease Patients
Protocol code: TRB-PD-001
Sponsor: Tridem Bioscience FlexCo (Pharmaceutical company). Phase: Human Pharmacology (Phase I)- First administration to humans. Countries: Austria (authorised, recruitment pending).
Therapeutic area(s): Diseases [C] - Nervous System Diseases [C10]
Gender: Female, Male. Age: 18-64 years, 65+ years. Enrolment: 18.
Status: Authorised, recruitment pending. Decision date: 2026-07-10. Results received: No. Last updated: 2026-07-14.

Condition(s): Parkinson's disease

Source: https://euclinicaltrials.eu/ctis-public/view/2024-519123-14-00